EU clinical trial 2025-520906-36-00: Microdosing with a serotonergic agent for ADHD and emotion regulation: biological factors explaining and predicting treatment response
Protocol code: P155
Sponsor: Universiteit Maastricht (Educational Institution). Phase: Therapeutic exploratory (Phase II). Countries: Netherlands (not authorised).
Therapeutic area(s): Psychiatry and Psychology [F] - Mental Disorders [F03]; Psychiatry and Psychology [F] - Behavior and Behavior Mechanisms [F01]
Gender: Female, Male. Age: 18-64 years. Enrolment: 120.
Status: Not authorised. Decision date: 2026-05-11. Results received: No. Last updated: 2026-05-11.

Condition(s): Attention Deficit Hyperactivity Disorder (ADHD)
Product: D-lysergic acid diethylamide (LSD), 1mL of ethanol, 95% Vol.

Primary endpoint: ADHD symptoms, Emotion regulation, Sleep
Endpoint(s): Pharmacokinetic profile, Theta-beta power ratio, CYP2D6 functionality, Polygenic risk score

Source: https://euclinicaltrials.eu/ctis-public/view/2025-520906-36-00